EU clinical trial 2024-514887-14-00: Impact of dapagliflozin on vascular function in chronic kidney disease patients - (DAPA-VASC)
Protocol code: 2021/0188/HP
Sponsor: Centre Hospitalier Universitaire Rouen (Hospital/Clinic/Other health care facility). Phase: Therapeutic confirmatory (Phase III). Countries: France (ended).
Therapeutic area(s): Diseases [C] - Cardiovascular Diseases [C14]
Gender: Female, Male. Age: 0-17 years, 65+ years. Enrolment: 54.
Status: Ended. Start date (EU): 2022-10-18. End date (EU): 2024-12-31. Decision date: 2024-09-04. Results received: No. Last updated: 2025-02-21.

Condition(s): chronic kidney disease patients
Product: Film-coated tablets containing the same excipients than FORXIGA® 10 mg excipients (but not dapagliflozin), DAPAGLIFLOZIN

Primary endpoint: Change in the magnitude of brachial artery flow-mediated dilatation in response to reactive hyperemia after 12-week treatment with dapagliflozin or placebo
Endpoint(s): Change in the magnitude of radial artery flow-mediated dilatation in response to hand skin heating after 12-week treatment with dapagliflozin or placebo, Change in the plasma release of nitric oxide and epoxyeicosatrienoic acids induced by hand skin heating after 12-week treatment with dapagliflozin or placebo, Change in the plasma levels of pro-oxidant and pro-inflammatory lipid mediators 12-week treatment with dapagliflozin or placebo, Change in carotid artery elastic modulus, carotid-to-femoral pulse wave velocity and aortic augmentation index after 12-week treatment with dapagliflozin or placebo, Change in cardiac output, stroke volume, ejection fraction and left ventricular end-systolic elastance after 12-week treatment with dapagliflozin or placebo

Source: https://euclinicaltrials.eu/ctis-public/view/2024-514887-14-00